EU clinical trial 2023-509049-11-00: Phase III randomized clinical trial for stage III epithelial ovarian cancer randomizing between primary cytoreductive surgery with or without hyperthermic intraperitoneal chemotherapy: OVHIPEC-2
Protocol code: OVHIPEC-2
Sponsor: Het Nederlands Kanker Instituut-Antoni van Leeuwenhoek Ziekenhuis Stichting (Hospital/Clinic/Other health care facility). Phase: Therapeutic confirmatory (Phase III). Countries: France (ongoing, recruitment ended), Ireland (ongoing, recruitment ended), Netherlands (ongoing, recruitment ended), Italy (ongoing, recruitment ended), Denmark (ongoing, recruitment ended), Sweden (ongoing, recruitment ended), Germany (ongoing, recruitment ended).
Therapeutic area(s): Diseases [C] - Neoplasms [C04]
Gender: Female. Age: 18-64 years, 65+ years. Enrolment: 485.
Status: Ongoing, recruitment ended. Start date (EU): 2020-01-01. Decision date: 2024-04-29. Results received: No. Last updated: 2026-08-07.
Decision dates by country: IE: 2024-04-29, IT: 2024-05-13, SE: 2024-05-03, DK: 2024-04-29, DE: 2024-10-09, NL: 2024-05-03, FR: 2024-05-06

Condition(s): FIGO stage III ovarian cancer who are eligible for primary cytoreductive surgery resulting in non-residual disease, or residual disease up to 2.5 mm
Product: SODIUM THIOSULFATE, CARBOPLATINE MEDAC 10 mg/mL, solution à diluer pour perfusion, Avastin 25 mg/ml concentrate for solution for infusion., Cisplatine Accord 1 mg/ml concentraat voor oplossing voor infusie, Paclitaxel Eugia 6 mg/ml, solution à diluer pour perfusion

Primary endpoint: The primary endpoint is overall survival, defined as the time from randomization to the date of death from any cause. For subjects that are alive, their survival time will be censored at the date of last contact (“last known alive date”). Overall survival will be censored for subjects at the date of randomization if they were randomized but had no follow-up.
Endpoint(s): Recurrence-free survival is defined as the time between the date of randomization and the first date of documented disease progression or recurrence, as determined by the GCIG criteria (Appendix 1) , or death due to any cause, whichever occurs first (36). Disease recurrence or progression will be regularly evaluated via a standardized follow-up scheme and/or following clinical symptoms., The time to first subsequent anticancer treatment after first recurrent disease (TFST), The toxicity and morbidity will be reported until 30 days after the end of chemotherapy, using the Common Toxicity Criteria for Adverse Events (CTCAE v5.0) for all events, and using the Clavien-Dindo method for surgery-related events.

Source: https://euclinicaltrials.eu/ctis-public/view/2023-509049-11-00